EU clinical trial 2025-522726-12-00: Phase 1 study to investigate the pharmacokinetic profile and safety of 3 testosterone gel formulations in postmenopausal female participants.
Protocol code: EX007-101
Sponsor: Chemo Research S.L. (Pharmaceutical company). Phase: Human Pharmacology (Phase I)- Other. Countries: Spain (ended).
Therapeutic area(s): Not possible to specify
Gender: Female. Age: 18-64 years, 65+ years. Enrolment: 24.
Status: Ended. Start date (EU): 2025-12-16. End date (EU): 2026-05-04. Decision date: 2025-12-02. Results received: No. Last updated: 2026-04-30.
Decision dates by country: ES: 2025-12-15

Condition(s): No medical conditions.

Source: https://euclinicaltrials.eu/ctis-public/view/2025-522726-12-00